EU clinical trial 2026-526014-87-00: A Phase 1 first-in-human study to evaluate SAR448272 in adult participants
Protocol code: SAD20279-MAD20280
Sponsor: Sanofi-Aventis Recherche & Developpement (Pharmaceutical company). Phase: Human Pharmacology (Phase I)- First administration to humans. Countries: Germany (ongoing, recruiting).
Therapeutic area(s): Diseases [C] - Immune System Diseases [C20]
Gender: Female, Male. Age: 18-64 years, 65+ years. Enrolment: 147.
Status: Ongoing, recruiting. Start date (EU): 2026-07-21. Decision date: 2026-06-19. Results received: No. Last updated: 2026-08-07.

Condition(s): healthy volunteers, immunological diseases

Source: https://euclinicaltrials.eu/ctis-public/view/2026-526014-87-00